EU clinical trial 2022-500050-42-00: The effect of multiple doses of BI 425809 on the pharmacokinetics of multiple doses of a combination of ethinyl estradiol and levonorgestrel following oral administration in healthy premenopausal female subjects (an open-label, twoperiod, fixed sequence design trial with run-in period)
Protocol code: 1346-0036
Sponsor: Boehringer Ingelheim International GmbH (Pharmaceutical company). Phase: Human Pharmacology (Phase I)- Other. Countries: Germany (ended).
Therapeutic area(s): Phenomena and Processes [G] - Reproductive and Urinary Physiological Phenomena [G08]
Gender: Female. Age: 18-64 years. Enrolment: 16.
Status: Ended. Start date (EU): 2022-11-24. End date (EU): 2023-10-04. Decision date: 2022-11-10. Results received: Yes. Last updated: 2022-11-10.

Condition(s): Healthy
Product: Microgynon, 150 Mikrogramm / 30 Mikrogramm, überzogene Tabletten, LEVONORGESTREL, ETHINYLESTRADIOL

Primary endpoint: AUCτ,ss (area under the concentration-time curve of the analyte in plasma at steady state over a uniform dosing interval τ), Cmax,ss (maximum measured concentration of the analyte in plasma at steady state over a uniform dosing interval τ), Cmin,ss (minimum measured concentration of the analyte in plasma at steady state over a uniform dosing interval τ)

Source: https://euclinicaltrials.eu/ctis-public/view/2022-500050-42-00